EU clinical trial 2024-513860-25-00: A Phase I Clinical Study to Evaluate the Safety, Tolerability, Pharmacokinetics and Clinical Activity of GSK5733584 for Injection in Subjects with Advanced Solid Tumors
Protocol code: 222730
Sponsor: Glaxosmithkline Research & Development Limited (Pharmaceutical company). Phase: Phase I and Phase II (Integrated)- Other. Countries: France (ongoing, recruiting), Sweden (ongoing, recruiting), Italy (ongoing, recruiting), Belgium (ongoing, recruiting), Spain (ongoing, recruiting), Finland (ongoing, recruiting), Netherlands (ongoing, recruiting), Germany (ongoing, recruiting).
Therapeutic area(s): Diseases [C] - Neoplasms [C04]
Gender: Female, Male. Age: 18-64 years, 65+ years. Enrolment: 143.
Status: Ongoing, recruiting. Start date (EU): 2024-12-10. Decision date: 2024-10-22. Results received: No. Last updated: 2026-02-23.
Decision dates by country: NL: 2024-10-23, SE: 2024-10-24, IT: 2024-10-22, BE: 2024-10-25, FR: 2024-10-24, FI: 2024-10-23, DE: 2026-02-23, ES: 2024-10-22

Condition(s): Ovarian Neoplasms

Source: https://euclinicaltrials.eu/ctis-public/view/2024-513860-25-00